EU clinical trial 2022-500801-41-00: A trial to test if different amounts of KTX-1001 are safe and tolerable in people with the bone marrow cancer multiple myeloma that has come back or where treatment did not work.
Protocol code: K36-MMSET-001
Sponsor: K36 Therapeutics Inc. (Pharmaceutical company). Phase: Human Pharmacology (Phase I)- First administration to humans. Countries: Spain (ongoing, recruiting), France (ongoing, recruiting).
Therapeutic area(s): Diseases [C] - Hemic and Lymphatic Diseases [C15]
Gender: Female, Male. Age: 18-64 years, 65+ years. Enrolment: 24.
Status: Ongoing, recruiting. Start date (EU): 2023-07-26. Decision date: 2023-03-06. Results received: No. Last updated: 2026-06-26.
Decision dates by country: ES: 2023-03-07, FR: 2023-04-24

Condition(s): Relapsed and Refractory Multiple Myeloma

Source: https://euclinicaltrials.eu/ctis-public/view/2022-500801-41-00